EU clinical trial 2023-510160-12-00: A randomized phase 3 trial of fludarabine/cytarabine/gemtuzumab ozogamicin with or without venetoclax in children with relapsed AML
Protocol code: ITCC-101/APAL2020D
Sponsor: Prinses Maxima Centrum voor Kinderoncologie B.V. (Hospital/Clinic/Other health care facility). Phase: Therapeutic confirmatory (Phase III). Countries: Czechia (ongoing, recruiting), Netherlands (ongoing, recruiting), France (ongoing, recruiting), Denmark (authorised, recruiting), Spain (ongoing, recruiting), Portugal (ongoing, recruiting), Norway (ongoing, recruiting), Belgium (ongoing, recruiting), Italy (ongoing, recruiting), Ireland (ended), Finland (ongoing, recruiting), Austria (ongoing, recruiting), Sweden (authorised, recruiting), Germany (ongoing, recruiting).
Therapeutic area(s): Diseases [C] - Neoplasms [C04]
Gender: Female, Male. Age: 0-17 years, 18-64 years. Enrolment: 82.
Start date (EU): 2022-08-16. Decision date: 2024-07-15. Results received: No. Last updated: 2026-06-08.
Decision dates by country: AT: 2024-07-22, BE: 2024-07-18, CZ: 2024-07-17, FI: 2024-07-16, FR: 2024-07-22, IE: 2024-07-29, IT: 2024-08-05, PT: 2024-08-23, ES: 2024-08-01, NL: 2024-07-15, NO: 2024-07-18, DE: 2025-04-29, DK: 2024-07-22, SE: 2024-07-16

Condition(s): acute myeloid leukemia
Product: Venetoclax, Venetoclax, AZACITIDINE, CYTARABINE, Venetoclax, Venetoclax, FLUDARABINE, Venetoclax, Venetoclax, Venetoclax, GEMTUZUMAB, Venetoclax

Primary endpoint: The primary endpoint of the study is overall survival (OS). OS is defined as time from randomization until death of any cause.

Source: https://euclinicaltrials.eu/ctis-public/view/2023-510160-12-00